EU clinical trial 2022-502747-35-00: A Phase III Randomised, Double-Blind, Placebo-Controlled, Multicentre Study of Durvalumab in Combination with Chemotherapy and Bevacizumab, Followed by Maintenance Durvalumab, Bevacizumab and Olaparib in Newly Diagnosed Advanced Ovarian Cancer Patients (DUO-O).
Protocol code: DUO-O/D081RC00001
Sponsor: AstraZeneca AB (Pharmaceutical company). Phase: Therapeutic confirmatory (Phase III). Countries: Belgium (ended), Italy (ended), Spain (ended), France (ended), Finland (ended), Bulgaria (ended), Denmark (ended), Romania (ended), Hungary (ended), Austria (ended), Germany (ended), Poland (ended).
Therapeutic area(s): Diseases [C] - Neoplasms [C04]
Gender: Female. Age: 18-64 years, 65+ years. Enrolment: 825.
Status: Ended. Start date (EU): 2019-02-18. End date (EU): 2026-04-20. Decision date: 2024-10-04. Results received: No. Last updated: 2026-05-22.
Decision dates by country: FI: 2024-10-09, PL: 2024-10-09, ES: 2024-10-07, RO: 2024-10-09, BE: 2024-10-08, AT: 2024-10-07, FR: 2024-10-04, BG: 2024-10-07, IT: 2024-10-21, HU: 2024-10-04, DK: 2024-10-08, DE: 2024-10-07

Condition(s): Newly diagnosed advanced (FIGO stage III-IV) high grade epithelial ovarian, fallopian or primary peritoneal cancer
Product: Lynparza 100 mg film-coated tablets, Sodium Chloride Intravenous Infusion BP 0.9% w/v Solution for Infusion (not authorised), Placebo film-coated tablet (Not Authorised), Lynparza 150 mg film-coated tablets, IMFINZI 50 mg/mL concentrate for solution for infusion., MYCOPHENOLATE MOFETIL, INFLIXIMAB, BEVACIZUMAB

Primary endpoint: Progression Free Survival (PFS) is defined as the time from randomisation to the date of objective disease progression or death (by any cause in the absence of progression) regardless of whether the patient withdraws from assigned therapy or receives another anticancer therapy prior to progression.
Endpoint(s): Progression Free Survival (PFS), Overall Survival (OS), Second Progression (PFS2), Objective Response Rate (ORR), Duration of response (DoR), Time to first subsequent therapy (TFST), Time to second subsequent therapy (TSST), Time to discontinuation or death (TDT), Pathological complete response (pCR), Health related Quality of Life (HRQoL), Pharmacokinetic and Immunogenicity

Source: https://euclinicaltrials.eu/ctis-public/view/2022-502747-35-00